EU clinical trial 2023-509322-22-00: Neoadjuvant pembrolizumab with a watch-and-wait strategy for patients with mismatch repair-deficient or microsatellite instability-high (dMMR/MSI-H) localized colon cancer: a randomized GERCOR G-109 PRODIGE 84 PREMICES phase II trial
Sponsor: Gercor (Pharmaceutical company). Phase: Therapeutic exploratory (Phase II). Countries: France (temporarily halted).
Therapeutic area(s): Diseases [C] - Digestive System Diseases [C06]
Gender: Female, Male. Age: 18-64 years, 65+ years. Enrolment: 60.
Status: Temporarily halted. Start date (EU): 2025-11-26. Decision date: 2025-03-20. Results received: No. Last updated: 2026-06-17.

Condition(s): localized colon cancer
Product: FLUOROURACIL, OXALIPLATIN, KEYTRUDA 25 mg/mL concentrate for solution for infusion, CAPECITABINE

Primary endpoint: The rate of success of the experimental strategy at 6 months or after two successive colonoscopies (corresponding to timepoint at 6 months from the experimental strategy) following randomization
Endpoint(s): The rate of strategy success at 24 months after randomization in the experimental arm, Safety (according to NCI CTCAE v 5.0) of experimental strategy, 3. OS at 6, 12 and 24 months in both study arms, EFS at 6, 12 and 24 months in both study arms, 30-day postoperative morbidity (the Clavien Dindo classification15 recommended) in patients operated in both treatment arms, Participant-reported symptoms, functioning and HRQoL (EORTC QLQ-C30; EORTC QLQ-CR29) at baseline, 3, 6, 12, and 24 months in both study arms, TRG (according to the Becker/Mandar system and the AJCC TNM system),, Endoscopic complete response (eCR)

Source: https://euclinicaltrials.eu/ctis-public/view/2023-509322-22-00